EU clinical trial 2023-504852-89-00: FMT-SPA - RANDOMIZED DOUBLE BLIND CONTROLLED STUDY ASSESSING THE EFFICACY OF FECAL MICROBIOTA TRANSPLANTATION IN PATIENTS WITH AXIAL SPONDYLOARTHRITIS RESISTANT TO CONVENTIONAL TREATMENT
Protocol code: APHP220934
Sponsor: Assistance Publique Hopitaux De Paris (Hospital/Clinic/Other health care facility). Phase: Therapeutic exploratory (Phase II). Countries: France (ongoing, recruiting).
Therapeutic area(s): Diseases [C] - Musculoskeletal Diseases [C05]
Gender: Female, Male. Age: 18-64 years, 65+ years. Enrolment: 25.
Status: Ongoing, recruiting. Start date (EU): 2025-04-07. Decision date: 2024-02-01. Results received: No. Last updated: 2026-08-04.

Condition(s): AXIAL SPONDYLOARTHRITIS
Product: Placebo is an inert coated capsule with no microbiota (active substance) inside. It is composed of a mix of coloring agents and partially pre-gelatinized corn starch in Hydroxypropyl methylcellulose capsule., MaaT033

Primary endpoint: Two co-primary endpoints, in a hierarchical design: 1. Variation of MSP between baseline and D42, 2. The proportion of patients satisfying ASAS 20 improvement criteria at D42, by randomisation group
Endpoint(s): A superior efficacy of FMT over placebo to correct dysbiosis at D42, defined by an increase in OTU richness in the FMT group, superior to variation in the placebo group, A correction of dysbiotic fecal microbiota at D28, D84 and D168 in FMT-treated group defined by an average increase of at least 65 MSP as compared to baseline (D0), A superior efficacy of FMT over placebo to correct dysbiosis at D28, D84 and D168 defined by an increase in MSP richness in the FMT group, superior to variation in the placebo group, A clinical improvement during the 168 days follow-up after FMT defined by a greater proportion of patients satisfying ASAS20 improvement criteria as compared to baseline (D0), throughout this period in the FMT group, as compared to the placebo group, A clinical improvement during the 168 days follow-up after FMT defined by a greater proportion of patients satisfying ASAS40 improvement criteria as compared to baseline (D0), at D28, D42, D84 and D168 in the FMT group, as compared to the placebo group, A greater achievement of a partial remission according to the ASAS definition at D28, D42, D84 and D168 in the FMT group, as compared to the placebo group, An improvement of biological inflammation assessed by CRP levels variation, between baseline (D0) and D28, D42, D84 and D168 in the FMT group, as compared to the placebo group, An improvement of ASDAS_CRP at D28, D42, D84 and D168, as compared to baseline (D0) greater in the FMT group, as compared to the placebo group, An improvement of Bath Ankylosing Spondylitis Metrology Index (BASMI) at D28, D42, D84 and D168, as compared to baseline (D0) greater in the FMT group, as compared to the placebo group, An improvement of MASES at D28, D42, D84 and D168, as compared to baseline (D0) greater in the FMT group, as compared to the placebo group, A decrease of non-steroidal anti-inflammatory drugs (NSAID) intake score at D28, D42, D84 and D168, as compared to baseline (D0) greater in the FMT group, as compared to the placebo group

Source: https://euclinicaltrials.eu/ctis-public/view/2023-504852-89-00